EU clinical trial 2022-501527-24-00: Phase I/II study to determine the safety and efficacy of Ribociclib in combination with hormone therapy and hypofractionated radiotherapy in breast cancer, with positive hormone receptors and negative HER2 status, in newly diagnosed, not immediately operable (or wishing to avoid surgery), elderly patient
Protocol code: CALHYS
Sponsor: Centre Antoine Lacassagne (Health care). Phase: Phase I and Phase II (Integrated)- Other. Countries: France (ended).
Therapeutic area(s): Diseases [C] - Neoplasms [C04]
Gender: Female. Age: 65+ years. Enrolment: 85.
Status: Ended. Start date (EU): 2025-01-24. End date (EU): 2026-03-26. Decision date: 2023-04-03. Results received: No. Last updated: 2026-03-20.

Condition(s): breast cancer
Product: Kisqali 200 mg film‑coated tablets, RIBOCICLIB

Primary endpoint: • Phase 1 For this purpose (primary end-point), the frequencies of the toxicity limiting doses will be determined during the 8 weeks of radiotherapy concomitant with the Ribociclib and hormone therapy and during the 3 months of post-radiotherapy follow-up. Toxicities are considered to be limiting if they are leading to discontinuation of treatment (cf dose adaptation in paragraph 6.4.1). The toxicities will be evaluated according to the CTCAE V4.03 scale., • Phase 2:The primary endpoint will be the rate of non-progression at 24-months, defined as the percentage of patients who are alive and have not progressed 24 months after the completion of the Ribociclib and Radiotherapy concomitant phase. The objective response rate will be defined as the sum of complete response and partial response 24 months after the end of the Ribociclib and Radiotherapy concomitant phase divided by the number of evaluable patients.
Endpoint(s): The overall tolerance of Ribociclib during the patient’s length of participation will be evaluated using clinical and biological assessment and graded according to the CTCAE V4.03 scale., The overall survival at 24 and 60 months after the end of Ribociclib and Radiotherapy concomitant phase is defined as the time from the inclusion to death whatever the causes. Patients alive or lost at time of analysis will be censored at the date of the last known contact., The progression free survival at 24 and 60 months after the Ribociclib and Radiotherapy concomitant phase is defined as the time from the inclusion to progression, or death due to any cause whatever occurred first., The quality of life will be assessed with QLQ-C30, ELD14, and visual analog scale for pain severity measurement every 6 months until end of follow up., The treatment compliance will be assessed with the 8-item Morisky Medication Adherence Scale, The patient’s health status will be evaluated at inclusion with the Onco-geriatric questionnaire G8, clinical score to predict the early death at 100 days, Lee score, ADL, IADL, HS, Charlson, MNA, percentage of weight loss, MMSE, GDSA, Balducci, walking speed and then at 2 and 6 months and progression with the Onco-geriatric questionnaire MMSE, ADL, IADL, walking speed, percentage of weight loss, HS.

Source: https://euclinicaltrials.eu/ctis-public/view/2022-501527-24-00